EU clinical trial 2024-517732-21-00: Bioequivalence of Lisdexamfetamine dimesylate 10 mg Capsules in Healthy Participants Under Fasting Conditions.
Protocol code: BLCL-LIS-CAN-01
Sponsor: Pharmaplot P.C. (Pharmaceutical company). Phase: Human Pharmacology (Phase I)- Bioequivalence Study. Countries: Portugal (authorised, recruitment pending).
Therapeutic area(s): Not possible to specify
Gender: Female, Male. Age: 18-64 years. Enrolment: 24.
Status: Authorised, recruitment pending. Decision date: 2024-12-20. Results received: No. Last updated: 2024-12-20.

Condition(s): No medical condition.

Source: https://euclinicaltrials.eu/ctis-public/view/2024-517732-21-00